EU clinical trial 2022-500264-35-00: First-in-Human Study of RLY-2608 in Advanced Breast Cancer and Other Solid Tumors.
Protocol code: RLY-2608-101
Sponsor: Relay Therapeutics Inc. (Pharmaceutical company). Phase: Human Pharmacology (Phase I)- First administration to humans. Countries: Spain (ongoing, recruiting), France (ongoing, recruiting), Italy (ongoing, recruiting).
Therapeutic area(s): Diseases [C] - Neoplasms [C04]
Gender: Female, Male. Age: 18-64 years, 65+ years. Enrolment: 305.
Status: Ongoing, recruiting. Start date (EU): 2022-10-28. Decision date: 2022-08-19. Results received: No. Last updated: 2026-03-18.
Decision dates by country: IT: 2022-08-22, ES: 2022-08-16, FR: 2022-12-15

Condition(s): Advanced solid tumor with a PIK3CA mutation in blood and/or tumor per local assessment.

Source: https://euclinicaltrials.eu/ctis-public/view/2022-500264-35-00